EU clinical trial 2022-501980-42-00: A Phase 3, Open-label, Uncontrolled Study to Evaluate the Activity, Safety, Pharmacokinetics and Pharmacodynamics of Roxadustat for the Treatment of Anemia in Pediatric Participants with Chronic Kidney Disease
Protocol code: 1517-CL-1003
Sponsor: Astellas Pharma Global Development Inc. (Pharmaceutical company). Phase: Therapeutic confirmatory (Phase III). Countries: Slovakia (ongoing, recruiting), Germany (ongoing, recruiting), Denmark (authorised, recruiting), Italy (ongoing, recruiting), Belgium (ongoing, recruiting), Norway (ongoing, recruiting), Czechia (authorised, recruiting), Spain (ongoing, recruiting), Portugal (not authorised), Romania (ongoing, recruiting), France (not authorised), Poland (ongoing, recruiting), Sweden (ongoing, recruiting), Greece (ongoing, recruiting), Ireland (ongoing, recruiting), Finland (ongoing, recruiting), Lithuania (ongoing, recruiting), Bulgaria (ended), Croatia (ongoing, recruiting), Netherlands (ongoing, recruiting).
Therapeutic area(s): Diseases [C] - Hemic and Lymphatic Diseases [C15]
Gender: Female, Male. Age: 0-17 years. Enrolment: 41.
Start date (EU): 2023-12-21. Decision date: 2023-11-07. Results received: No. Last updated: 2026-02-25.
Decision dates by country: FR: 2023-11-09, PT: 2023-11-13, IT: 2023-11-07, IE: 2024-02-23, SE: 2024-03-04, GR: 2024-03-11, LT: 2024-03-04, HR: 2024-05-17, RO: 2023-11-13, BG: 2024-07-01, FI: 2024-03-20, BE: 2023-11-10, NO: 2023-11-10, ES: 2023-11-13, SK: 2023-11-07, NL: 2024-06-28, CZ: 2023-11-10, DK: 2023-11-07, PL: 2023-11-10, DE: 2023-11-07

Condition(s): Anemia associated with Chronic Kidney Disease
Product: roxadustat 5 mg azo-dye free tablets, ERYTHROPOIETIN, roxadustat 50 mg azo-dye free tablets, METHOXY POLYETHYLENE GLYCOL-EPOETIN BETA, roxadustat 20 mg azo-dye free tablets, DARBEPOETIN ALFA

Primary endpoint: Change in Hb level between baseline (before start of dosing) and average Hb level over treatment weeks 20 to 24. The 24-week treatment period is defined as 4 weeks of fixed dose treatment followed by 20 weeks of dose titration(s)
Endpoint(s): 1●PK parameters: Cmax, AUC, CL/F, Tmax; ●PD assessments: Hb level and dose titration history at all timepoints, 2● Number and percent of TEAEs ● Number and percent of treatment-emergent cardiovascular and thrombotic AEs ● Tabulations of safety assessments (clinical laboratory tests, vital signs, growth parameters and physical examinations), 3a●Percentage of participants achieving 2 consecutive Hb values within 1 g/dL of baseline (ESA-treated participants only) or achieving the target range of 10.0 to 12.0 g/dL at the end of the 24-week treatment period ● Summaries of monthly IV iron usage (number of IV iron administrations and total IV iron dosage), 3b●Percentage of participants using IV iron by study period (day 1 to week 24 and week 25 to week 52/EOT) ●Percentage of participants using oral iron by study period (day 1 to week 24 and week 25 to week 52/EOT) ● Percentage of participants using rescue therapy by study period (day 1 to week 24, week 25 to week 52/EOT, and overall), 4● Summaries overall and by age group (adolescents and children) for responses on the 5-point Likert Scale on palatability, taste and ability to swallow oral roxadustat at weeks 4, 24 and 52/EOT, 5●Summaries overall, by age group (adolescents and children), and by visit (day 1, weeks 8 to 52/EOT), for QoL ePRO assessments scores and changes from baseline ● Pediatric Quality of Life Inventory version 4.0 ● Pediatric Quality of Life Multidimensional Fatigue Scale standard version

Source: https://euclinicaltrials.eu/ctis-public/view/2022-501980-42-00